EU clinical trial 2025-521745-25-00: A Phase 2b, Randomized, Double-Blind, Placebo-Controlled Study to Evaluate the Efficacy and Safety of Tulisokibart in Participants With Rheumatoid Arthritis
Protocol code: MK-7240-014
Sponsor: Merck Sharp & Dohme LLC (Pharmaceutical company). Phase: Therapeutic exploratory (Phase II). Countries: Poland (ongoing, recruitment ended), Spain (ongoing, recruitment ended), Germany (ongoing, recruitment ended).
Therapeutic area(s): Diseases [C] - Immune System Diseases [C20]
Gender: Female, Male. Age: 18-64 years, 65+ years. Enrolment: 56.
Status: Ongoing, recruitment ended. Start date (EU): 2025-11-06. Decision date: 2025-10-27. Results received: No. Last updated: 2026-07-30.
Decision dates by country: ES: 2025-10-27, DE: 2025-10-28, PL: 2025-10-31

Condition(s): Rheumatoid Arthritis
Product: tulisokibart, Placebo to MK-7240 (tulisokibart)

Primary endpoint: Proportion of Participants Achieving American College of Rheumatology 20% Response Criteria (ACR20) at Week 12
Endpoint(s): Proportion of Participants Achieving American College of Rheumatology 50% Response Criteria (ACR50) at Week 12, Proportion of Participants Achieving American College of Rheumatology 70% Response Criteria (ACR70) at Week 12, Proportion of Participants Achieving Low Disease Activity (LDA) based on Disease Activity Score 28 Using C-Reactive Protein (DAS28-CRP), Change From Baseline in the Health Assessment Questionnaire Disability Index (HAQ-DI) Score at Week 12, Number of Participants Who Experience One or More Adverse Events (AEs), Number of Participants Who Discontinue Study Intervention Due to an AE

Source: https://euclinicaltrials.eu/ctis-public/view/2025-521745-25-00